EU clinical trial 2023-508730-34-00: A Phase 1b/2, multicenter, open-label platform study of select immunotherapy combinations in adult participants with previously untreated advanced non-small cell lung cancer (NSCLC) with high PD-L1 expression
Protocol code: SPLFIO-174
Sponsor: Institut De Recherches Internationales Servier IRIS (Pharmaceutical company). Phase: Phase I and Phase II (Integrated)- Other. Countries: France (temporarily halted), Spain (temporarily halted), Hungary (temporarily halted), Austria (temporarily halted), Italy (temporarily halted), Belgium (temporarily halted), Romania (temporarily halted).
Therapeutic area(s): Diseases [C] - Neoplasms [C04]
Gender: Female, Male. Age: 18-64 years, 65+ years. Enrolment: 86.
Status: Temporarily halted. Start date (EU): 2024-07-10. Decision date: 2024-06-17. Results received: No. Last updated: 2026-07-28.
Decision dates by country: BE: 2024-10-01, AT: 2024-06-24, RO: 2024-10-25, FR: 2024-06-17, HU: 2024-06-18, ES: 2024-06-21, IT: 2024-07-25

Condition(s): Non-small cell lung cancer (NSCLC): - Locally advanced NSCLC where participants are not candidates for surgical resection and/or definitive chemoradiation, or - Metastatic NSCLC
Product: S095018/Sym023, LIBTAYO 350 mg concentrate for solution for infusion., S095024/Sym024, S095029/Sym025

Primary endpoint: Part A (combination therapy safety lead-in): Incidence and severity of dose-limiting toxicities (DLTs) during the first 2 cycles of combination treatment, Part A (combination therapy safety lead-in): Incidence and severity of adverse events (AEs), serious adverse events (SAEs), changes from baseline in laboratory values/laboratory abnormalities, electrocardiograms (ECGs) and vital signs according to National Cancer Institute Common Terminology Criteria for Adverse Events (NCI-CTCAE v5.0), Part A (combination therapy safety lead-in): AEs leading to dose interruption, modification, delays, and permanent treatment discontinuation, Part B (Randomized dose expansion): Objective Response (OR) per investigator assessment using RECIST v1.1
Endpoint(s): Part A (combination therapy safety lead-in): Objective response (OR) according to Response Evaluation Criteria in Solid Tumors (RECIST) v1.1 and immune Response Evaluation Criteria in Solid Tumors (iRECIST) as assessed by the investigator, Part B (Randomized dose expansion): Objective response (OR) according to immune Response Evaluation Criteria in Solid Tumors (iRECIST) as assessed by the investigator, Part A (combination therapy safety lead-in) and Part B (Randomized dose expansion): best overall response (BOR), duration of response (DoR), disease control (DC), 6-month durable response (6-month DR) and Progression-Free Survival (PFS), according to Response Evaluation Criteria in Solid Tumors (RECIST) v1.1 and immune RECIST (iRECIST) as assessed by the investigator, Part A (combination therapy safety lead-in) and Part B (Randomized dose expansion): Overall survival (OS), Part A (combination therapy safety lead-in) and Part B (Randomized dose expansion): Plasma or serum concentrations of S095018, S095024 or S095029, Part A (combination therapy safety lead-in) and Part B (Randomized dose expansion): Incidence and titer of anti-drug antiodies (ADA) directed against S095018, S095024 or S095029, Part B (Randomized dose expansion): Incidence and severity of adverse events (AEs), serious adverse events (SAEs), changes in laboratory values/laboratory abnormalities, ECGs and vital signs according to NCI-CTCAE v5.0, Part B (Randomized dose expansion): AEs leading to dose interruption, modification, delays, and permanent treatment discontinuation

Source: https://euclinicaltrials.eu/ctis-public/view/2023-508730-34-00